EU clinical trial 2024-515394-10-00: Phase I/II, Multicenter, Open-label, Clinical and Pharmacokinetic Study of Lurbinectedin in Combination with Irinotecan in Pretreated Patients with Selected Advanced Solid Tumors
Protocol code: PM1183-A-014-15
Sponsor: Pharma Mar S.A. (Pharmaceutical company). Phase: Phase I and Phase II (Integrated)- Other. Countries: Spain (ended), France (ended), Italy (ended).
Therapeutic area(s): Diseases [C] - Neoplasms [C04]
Gender: Female, Male. Age: 18-64 years, 65+ years. Enrolment: 247.
Status: Ended. Start date (EU): 2016-04-26. End date (EU): 2025-05-21. End date: 2025-07-02. Decision date: 2024-08-20. Results received: Yes. Last updated: 2025-05-05.
Decision dates by country: IT: 2024-09-16, FR: 2024-08-23, ES: 2024-08-20

Condition(s): Selected Advanced Solid Tumors
Product: IRINOTECAN, lurbinectedin

Primary endpoint: Phase I Escalation Stage: Determination of MTD and RD, Phase II Expansion Stage: Efficacy
Endpoint(s): Safety, Pharmacokinetics, Efficacy (Secondary Endpoint in the Phase I Escalation Stage), Pharmacogenomics, Pharmacogenetics

Source: https://euclinicaltrials.eu/ctis-public/view/2024-515394-10-00